EU clinical trial 2023-506906-38-00: A Phase 3, Multicenter, Randomized, Open-Label Trial to Evaluate the Safety and Efficacy of Epcoritamab + Rituximab and Lenalidomide (R2) compared to Chemoimmunotherapy in Previously Untreated Follicular Lymphoma (EPCORE™FL-2)
Protocol code: M22-003
Sponsor: AbbVie Deutschland GmbH & Co. KG (Pharmaceutical company). Phase: Therapeutic confirmatory (Phase III). Countries: Denmark (ongoing, recruitment ended), Greece (ongoing, recruitment ended), Netherlands (ongoing, recruitment ended), Portugal (ongoing, recruitment ended), Czechia (ongoing, recruitment ended), France (ongoing, recruitment ended), Hungary (ongoing, recruitment ended), Bulgaria (ongoing, recruitment ended), Italy (ongoing, recruitment ended), Germany (ongoing, recruitment ended), Spain (ongoing, recruitment ended), Romania (ongoing, recruitment ended), Croatia (ongoing, recruitment ended), Sweden (ended), Belgium (ongoing, recruitment ended), Slovakia (ongoing, recruitment ended), Poland (ongoing, recruitment ended).
Therapeutic area(s): Diseases [C] - Neoplasms [C04]
Gender: Female, Male. Age: 18-64 years, 65+ years. Enrolment: 357.
Start date (EU): 2024-05-23. Decision date: 2024-04-29. Results received: No. Last updated: 2026-01-20.
Decision dates by country: IT: 2024-04-29, FR: 2024-04-29, SE: 2024-04-30, RO: 2024-04-30, BG: 2024-04-30, PT: 2024-04-30, CZ: 2024-05-02, NL: 2024-04-30, ES: 2024-04-29, HR: 2024-04-30, DK: 2024-04-29, PL: 2024-05-02, BE: 2024-04-30, HU: 2024-04-29, SK: 2024-04-30, GR: 2024-05-02, DE: 2024-05-02

Condition(s): Follicular Lymphoma
Product: Bendamustine 100 mg Powder for concentrate for Solution for Infusion, Truxima 100 mg concentrate for solution for infusion, RoActemra 20 mg/mL concentrate for solution for infusion, PREDNISONE BIOGARAN 20 mg, scored tablet, Cyclophosphamide Injection 500 mg., Doxorubicin 2 mg/ml Solution for Injection., Truxima 500 mg concentrate for solution for infusion, Vincristine Sulfate 1 mg/ml solution for injection, Revlimid 5 mg hard capsules, Epcoritamab (GEN3013), Epcoritamab (GEN3013), Revlimid 20 mg hard capsules, Gazyvaro 1,000 mg concentrate for solution for infusion.

Primary endpoint: The primary endpoint is the Complete Response rate at 30 months/120 weeks (CR30) in Arm A1 (ER2) versus Arm B (CIT), as determined by PET-CT per Lugano 2014 criteria, as assessed by IRC.
Endpoint(s): OS, MRD negativity rate, PROs: Change from baseline in physical functioning (assessed by the physical functioning scale of the EORTC QLQ-C30) at Week 21 for Arm A1 and Week 21 (G/R-Benda regimen)/22 (G/R-CHOP regimen) for Arm B.

Source: https://euclinicaltrials.eu/ctis-public/view/2023-506906-38-00